EU clinical trial 2025-525153-39-00: Effect of vasopressin versus norepinephrine on post-operative mean pulmonary arterial pressure following pulmonary endarterectomy surgery, a randomized open label trial
Protocol code: AOR24060
Sponsor: Fondation Hopital Saint Joseph (Hospital/Clinic/Other health care facility). Phase: Therapeutic confirmatory (Phase III). Countries: France (authorised, recruitment pending).
Therapeutic area(s): Diseases [C] - Respiratory Tract Diseases [C08]; Phenomena and Processes [G] - Circulatory and Respiratory Physiological Phenomena [G09]; Diseases [C] - Cardiovascular Diseases [C14]
Gender: Female, Male. Age: 18-64 years, 65+ years. Enrolment: 90.
Status: Authorised, recruitment pending. Decision date: 2026-05-12. Results received: No. Last updated: 2026-08-07.

Condition(s): Chronic thromboembolic pulmonary hypertension
Product: Reverpleg 40 U.I./2 ml solution à diluer pour perfusion, NORADRENALINE VIATRIS 2 mg/ml SANS SULFITES, solution à diluer pour perfusion

Primary endpoint: mPAP in millimeter of mercury (mmHg) measured by the Swan-Ganz catheter in the operating room, specifically recorded at the end of skin closure immediately following the completion of the PEA procedure
Endpoint(s): mPAP (mmHg) measured by the Swan-Ganz catheter - Vascular pulmonary resistance (in wood unit) measured by the Swan-Ganz catheter;, Vascular pulmonary resistance (in wood unit) measured by the Swan-Ganz catheter;, Cardiac output (in liter per minute, l/min) measured by the Swan-Ganz catheter;, Pulmonary artery compliance measured by the Swan Ganz catheter;, Defined as the necessity for inotropic support and/or mechanical circulatory assistance, i.e., veno-venous or veno-arterial extracorporeal membrane oxygenation (ECMO) for weaning CPB;, Defined according to KDIGO classification or the need for renal replacement therapy;, Defined by at least one documented episode of atrial fibrillation or atrial flutter;, Defined by any airway hemorrhage with at least one local treatment: local application of vasoactive substance, bronchial exclusion, embolization, or salvage surgery;, Defined by the occurrence of at least (composite outcome): failure to wean off invasive mechanical ventilation and sedatives, need for neuromuscular blockers, inhaled NO, prone positioning, pneumonia, ICU readmission for acute respiratory failure or need for respiratory support (noninvasive or invasive ventilation);, Defined as an acute coronary syndrome during the hospital stay;, Defined as mesenteric or colonic ischemia confirmed by imaging or endoscopy;, Defined as acute stroke (ischemic or hemorrhagic), confusion, or seizures;, Defined as the occurrence of surgical site infection according to the CDC definition;, Defined as any surgical reintervention of the surgical site during the first 30 days following surgery;, Calculated in days, from the time of admission (to ICU and hospital) until the time of discharge (from ICU and hospital) whatever the cause;, All-cause mortality.

Source: https://euclinicaltrials.eu/ctis-public/view/2025-525153-39-00